EU clinical trial 2024-515748-22-01: Danish trial of beta blocker treatment after myocardial infarction without reduced ejection fraction (DANBLOCK)
Protocol code: DANBLOCK
Sponsor: Frederiksberg Hospital (Hospital/Clinic/Other health care facility). Phase: Therapeutic confirmatory (Phase III). Countries: Denmark (ended).
Therapeutic area(s): Diseases [C] - Cardiovascular Diseases [C14]
Gender: Female, Male. Age: 18-64 years, 65+ years. Enrolment: 2760.
Status: Ended. Start date (EU): 2018-12-01. End date (EU): 2025-04-01. Decision date: 2024-08-22. Results received: Yes. Last updated: 2024-08-22.

Condition(s): Myocardinal infarction
Product: Carvedilol STADA 3,125 mg töflur., Metoprololsuccinat "Polpharma", depottabletter, Carvedilol STADA 12,5 mg töflur, Carvedilol STADA 25 mg töflur., Carvedilol STADA 6,25 mg Tabletten, Carvedilol STADA® 12,5 mg Tabletten, Bisoprolol Orion 2,5 mg tabletter, Bisoprolol Orion 5 mg tabletter, Bisoprolol Orion 10 mg tabletter, Bisoprolol Orion 5 mg tabletter, Metoprololsuccinat "Polpharma", depottabletter, Carvedilol STADA 6,25 mg töflur., Carvedilol STADA 12,5 mg tabletti, Carvedilol STADA 6,25 mg tabletti, Carvedilol STADA 3,125 mg tabletti, Carvedilol STADA® 6,25 mg Tabletten, Bisoprolol Orion 2,5 mg tabletter, Carvedilol STADA 25 mg tabletti, Carvedilol STADA® 25 mg Tabletten, Nebivolol Pliva 5 mg tablete, Bisoprolol Orion 2,5 mg tabletit, Bisoprolol Orion 10 mg tabletit, Carvedilol STADA 25 mg Tabletten, Bisoprolol Orion 5 mg tabletit, Bisoprolol Orion 10 mg tabletter, Carvedilol STADA 12,5 mg Tabletten, Metoprololsuccinat "Polpharma", depottabletter, Metoprololsuccinat "Polpharma", depottabletter

Primary endpoint: The composite outcome of recurrent MI, all-cause mortality, revascularization with percutaneous coronary intervention or coronary atery bypass graft, ischemic stroke, incident heart faliure, malignant ventricular arrythmia or resuscitated cardiac arrest.
Endpoint(s): Each of the components of the primary endpoint, i.e.: All-cause mortality, recurrent MI, revascularisation with PCI or CABG, ischemic stroke, incident heart failure, malignant ventricular arrhythmia, or resuscitated cardiac arrest., To assess clinical outcomes linked to beta-blocker therapy in the following subgroups: age, sex, BB dosage tertiles, STEMI vs. NSTEMI, and LVEF subgroups, To study whether oral beta-blocker therapy reduces the risk of cardiovascular death compared to no such therapy, To study whether oral beta-blocker therapy reduces the risk of stable and unstable angina compared to no such therapy, To study whether oral beta-blocker therapy reduces the risk of atrial fibrillation, atrial flutter or other atrial tachyarrhythmias compared to no such therapy, To study whether oral beta-blocker therapy increases the risk of hospitalization for bradycardia, syncope, implantation of pacemaker, To study whether oral beta-blocker therapy increases the risk of hospitalization for chronic obstructive pulmonary disease, asthma or peripheral artery disease., To study whether oral beta-blocker therapy increases the risk of hospitalization or outpatient visit for new-onset or dysregulated diabetes, To study whether oral beta-blocker therapy affects the following patient related outcomes: Quality of life, angina, dyspnoea, anxiety, depression, sexual dysfunction or sleep disorders., To conduct cost-utility analysis in relation to quality of life and a health economic evaluation including drug use, health care utilization, employment, income, and benefit take-up, To describe beta-blocker dosage and adherence, To assess study safety

Source: https://euclinicaltrials.eu/ctis-public/view/2024-515748-22-01